EU clinical trial 2024-516208-41-00: The Intensive Care Platform Trial (INCEPT)
Sponsor: Rigshospitalet (Hospital/Clinic/Other health care facility). Phase: Therapeutic use (Phase IV). Countries: Denmark (ongoing, recruiting), Finland (authorised, recruitment pending), Iceland (authorised, recruitment pending), Sweden (authorised, recruitment pending), Netherlands (authorised, recruitment pending).
Therapeutic area(s): Health Care [N] - Health Care Quality, Access, and Evaluation [N05]
Gender: Female, Male. Age: 18-64 years, 65+ years. Enrolment: 100000.
Start date (EU): 2025-06-26. Decision date: 2025-02-18. Results received: No. Last updated: 2026-06-22.
Decision dates by country: SE: 2026-02-27, FI: 2026-03-18, IS: 2026-03-30, NL: 2026-03-20, DK: 2025-02-18

Condition(s): Acute critical illness requiring intensive care unit admission.
Product: TINZAPARIN, ENOXAPARIN, NADROPARIN, ALBUMIN, DALTEPARIN

Primary endpoint: Each domain in INCEPT will use one of the outcomes listed below under 'secondary end points' as the primary - the primary outcome will thus differ between domains, but always be one of the secondary outcomes (the core outcome set defined in the core protocol).
Endpoint(s): All-cause 30-day mortality, All-cause 90-day mortality, All-cause 180-day mortality, Days alive without life support at day 30, Days alive without life support at day 90, Days alive out of hospital at day 30, Days alive out of hospital at day 90, Days free of delirium at day 30, EQ-5D-5L index values (health-related quality of life) at day 180, EQ VAS (health-related quality of life) at day 180, Cognitive function at day 180 (Montreal Cognitive Assessment test 5-minute version, v2.1 [“Mini MoCA”]), One or more domain-specific safety outcomes

Source: https://euclinicaltrials.eu/ctis-public/view/2024-516208-41-00